EU clinical trial 2024-516003-16-00: The Swedish Nationwide Clinical Trial to Facilitate Patient Access to Targeted Cancer Treatment based on Biomarker Profiling (FOCU.SE)
Protocol code: FOCU.SE
Sponsor: Vaestra Goetalandsregionen (Hospital/Clinic/Other health care facility). Phase: Therapeutic exploratory (Phase II). Countries: Sweden (authorised, recruitment pending).
Therapeutic area(s): Diseases [C] - Neoplasms [C04]
Gender: Female, Male. Age: 18-64 years, 65+ years. Enrolment: 0.
Status: Authorised, recruitment pending. Decision date: 2025-08-22. Results received: No. Last updated: 2026-06-22.

Condition(s): Advanced Cancer

Source: https://euclinicaltrials.eu/ctis-public/view/2024-516003-16-00